EU clinical trial 2023-506962-30-00: The effect of semaglutide in subjects with non-cirrhotic non-alcoholic steatohepatitis
Protocol code: NN9931-4553
Sponsor: Novo Nordisk A/S (Pharmaceutical company). Phase: Therapeutic confirmatory (Phase III). Countries: Romania (ongoing, recruitment ended), Netherlands (ongoing, recruitment ended), Denmark (ongoing, recruitment ended), Poland (ongoing, recruitment ended), France (ongoing, recruitment ended), Ireland (ongoing, recruitment ended), Belgium (ongoing, recruitment ended), Bulgaria (ongoing, recruitment ended), Portugal (ongoing, recruitment ended), Croatia (ended), Spain (ongoing, recruitment ended), Czechia (ongoing, recruitment ended), Germany (ongoing, recruitment ended), Slovakia (ongoing, recruitment ended), Italy (ongoing, recruitment ended), Norway (ongoing, recruitment ended), Austria (ongoing, recruitment ended), Greece (ongoing, recruitment ended).
Therapeutic area(s): Diseases [C] - Digestive System Diseases [C06]
Gender: Female, Male. Age: 18-64 years, 65+ years. Enrolment: 219.
Start date (EU): 2021-03-29. Decision date: 2024-05-13. Results received: No. Last updated: 2026-06-30.
Decision dates by country: BG: 2024-05-13, IE: 2024-05-13, CZ: 2024-05-15, PT: 2024-05-13, DE: 2024-05-17, RO: 2024-05-20, AT: 2024-06-24, GR: 2024-07-30, SK: 2024-05-13, BE: 2024-05-27, FR: 2024-05-17, NO: 2024-05-14, HR: 2024-05-14, ES: 2024-05-14, NL: 2024-05-13, DK: 2024-05-13, PL: 2024-05-20, IT: 2024-06-10

Condition(s): Non-alcoholic steatohepatitis (NASH)
Product: Semaglutide D 2.27 mg/mL DV3396, Semaglutide B 1.34 mg/mL PDS290 1.5 mL, Semaglutide D 2.0 mg/mL DV3396, Cartridge (glass) in pre-filled pen (PDS290 pen-injector): Semaglutide B placebo PDS290 pen-injector, 1.5 mL Semaglutide B placebo PDS290 pen-injector, 3 mL, Semaglutide B 0.68 mg/mL PDS290 1.5 mL, Semaglutide B 2.27 mg/mL PDS290 3.0 mL, Semaglutide D 1.0 mg/mL DV3396, Semaglutide B 1.34 mg/mL PDS290 3.0 mL, Wegovy 0.25 mg solution for injection in pre-filled pen, Semaglutide D 0.5 mg/mL DV3396, Wegovy 0.5 mg solution for injection in pre-filled pen, Wegovy 2.4 mg solution for injection in pre-filled pen, Wegovy 2.4 mg FlexTouch solution for injection in pre-filled pen, Wegovy 1.7 mg solution for injection in pre-filled pen, Pre-filled syringe (glass) in a pre-filled pen: Semaglutide placebo Ia DV3396 pen-injector, 0.5 mL Semaglutide placebo Ib DV3396 pen-injector, 0.75 mL, Semaglutide D 3.2 mg/mL DV3396, Wegovy 1 mg solution for injection in pre-filled pen, Semaglutide B 3.2 mg/mL PDS290 3.0 mL

Primary endpoint: Part 1 Resolution of steatohepatitis and no worsening of liver fibrosis (Yes/No) from randomisation (week 0) to week 72, Part 1 Improvement in liver fibrosis and no worsening of steatohepatitis (Yes/No) from randomisation (week 0) to week 72, Part 2 Cirrhosis-free survival (Yes/No) from randomisation (week 0) to week 240
Endpoint(s): Change in body weight from randomisation (week 0) to week 72, Resolution of steatohepatitis and improvement in liver fibrosis (Yes/No) from randomisation (week 0) to week 72, Change in SF-36 Bodily Pain from randomisation (week 0) to week 72, Change in body weight from randomisation (week 0) to week 240, Improvement in steatohepatitis with at least a 2-point reduction in NAS and no worsening of fibrosis (Yes/No) from randomisation (week 0) to week 72, Change in histology-assessed liver collagen proportionate area from randomisation (week 0) to week 72, Worsening in steatohepatitis (Yes/No) from randomisation (week 0) to week 72, Improvement in histology-assessed ballooning (Yes/No) from randomisation (week 0) to week 72, Improvement in histology-assessed inflammation (Yes/No) from randomisation (week 0) to week 72, Improvement in histology-assessed steatosis (Yes/No) from randomisation (week 0) to week 72, NASH resolution (ballooning of 0, inflammation of 0-1) and ≥2point NAS reduction with no worsening of fibrosis from randomisation (week 0) to week 72, Progression of liver fibrosis in patients with F2 at baseline (Yes/No) from randomisation (week 0) to week 72, Progression of liver fibrosis from randomisation (week 0) to week 72, Resolution of steatohepatitis and no worsening of liver fibrosis (Yes/No) from randomisation (week 0) to week 240, Improvement in liver fibrosis and no worsening of steatohepatitis (Yes/No) from randomisation (week 0) to week 240, Changes in liver stiffness values assessed by transient elastography (FibroScan®) from randomisation (week 0) to week 72 and week 240, Change in ELF score from randomisation (week 0) to week 72 and week 240, Change in ALT from randomisation (week 0) to week 72 and week 240, Change in AST from randomisation (week 0) to week 72 and week 240, Change in CAP values assessed by transient elastography (FibroScan) from randomisation (week 0) to week 72 and week 240, Change in FAST score from randomisation (week 0) to week 72 and week 240, Change in Pro-C3 from randomisation (week 0) to week 72 and week 240, Change in inflammation assessed by hsCRP from randomisation (week 0) to week 72 and week 240, Change in HbA1c from randomisation (week 0) to week 72 and week 240, Change in triglyceride from randomisation (week 0) to week 72 and week 240, Change in free fatty acids from randomisation (week 0) to week 72 and week 240, Change in LDL cholesterol from randomisation (week 0) to week 72 and week 240, Change in HDL cholesterol from randomisation (week 0) to week 72 and week 240, Time to first MACE (composite endpoint) from randomisation (week 0) to week 240, Major cardio-hepatic event-free survival (Yes/No) from randomisation (week 0) to week 240, Changes in SF-36 Physical Component Summary from randomisation (week 0) to week 72 and week 240, Changes in SF-36 Mental Component Summary from randomisation (week 0) to week 72 and week 240, Change in SF-36 Bodily Pain from randomisation (week 0) to week 240, Changes in NASH-CHECK Abdominal Pain from randomisation (week 0) to week 72 and week 240, Absence of histological evidence of NASH (Yes/No) from randomisation (week 0) to week 240

Source: https://euclinicaltrials.eu/ctis-public/view/2023-506962-30-00